EU clinical trial 2022-500811-37-00: A Phase 2 Study of Neoadjuvant Cemiplimab for Stage II to IV (M0) Cutaneous Squamous Cell Carcinoma (CSCC)
Protocol code: R2810-ONC-1901
Sponsor: Regeneron Pharmaceuticals Inc. (Pharmaceutical company). Phase: Therapeutic exploratory (Phase II). Countries: Germany (ended).
Therapeutic area(s): Not possible to specify; Diseases [C] - Neoplasms [C04]
Gender: Female, Male. Age: 18-64 years, 65+ years. Enrolment: 6.
Status: Ended. Start date (EU): 2021-01-19. End date (EU): 2025-11-19. End date: 2025-11-20. Decision date: 2022-09-16. Results received: No. Last updated: 2025-10-08.

Condition(s): Stage II to IV cutaneous squamous cell carcinoma
Product: LIBTAYO 350 mg concentrate for solution for infusion.

Primary endpoint: The primary endpoint is pathologic complete response (pCR) rate assessed by independent central pathology review
Endpoint(s): Major pathologic response (mPR) rate assessed by independent central pathology review, pCR rate assessed by local pathology review, mPR rate assessed by local pathology review, Objective response rate (ORR) prior to surgery, according to investigator assessment using RECIST 1.1, Event free survival (EFS), Disease free survival (DFS), Overall survival (OS), Incidence of adverse events (AEs), Incidence of serious adverse events (SAEs), Incidence of deaths, Incidence of laboratory abnormalities, Change in surgical plan in the screening period versus actual surgery after neoadjuvant cemiplimab, Change in post-surgical management plan in the screening period versus actual post-surgical management

Source: https://euclinicaltrials.eu/ctis-public/view/2022-500811-37-00